EU clinical trial 2023-508219-21-00: An open-label randomized trial of the efficacy and safety of zanidatamab with standard-of-care therapy against standard of-care therapy alone for advanced HER2 positive biliary tract cancer
Protocol code: JZP598-302
Sponsor: Jazz Pharmaceuticals Ireland Limited (Pharmaceutical company). Phase: Therapeutic confirmatory (Phase III). Countries: Germany (ongoing, recruiting), Belgium (ended), Spain (ongoing, recruiting), Finland (ended), Czechia (ended), France (ongoing, recruiting), Romania (ended), Portugal (ongoing, recruiting), Italy (ongoing, recruiting), Sweden (ended).
Therapeutic area(s): Diseases [C] - Neoplasms [C04]
Gender: Female, Male. Age: 18-64 years, 65+ years. Enrolment: 93.
Start date (EU): 2024-09-12. Decision date: 2024-08-12. Results received: No. Last updated: 2026-07-20.
Decision dates by country: RO: 2024-08-19, CZ: 2024-08-14, ES: 2024-08-13, SE: 2024-08-16, BE: 2024-08-12, PT: 2024-09-11, DE: 2024-08-16, IT: 2024-08-14, FI: 2024-08-15, FR: 2024-08-13

Condition(s): BTC - Biliary Tract Cancer
Product: PEMBROLIZUMAB, Gemcitabin Hikma 38 mg/ml Konzentrat zur Herstellung einer Infusionslösung, IMFINZI 50 mg/mL concentrate for solution for infusion., Cisplatinum Accord, 1 mg/ml, koncentrat do sporządzania roztworu do infuzji., JZP598

Primary endpoint: Progression-free survival (PFS) per the Response Evaluation Criteria in Solid Tumors, Version 1.1 (RECIST 1.1) in the immunohistochemistry (IHC) 3+ subgroup
Endpoint(s): Overall survival (OS) in the IHC 3+ subgroup, PFS per RECIST 1.1 in the overall population, OS in the overall population, Confirmed objective response rate (cORR) per RECIST 1.1, Duration of response (DOR) per RECIST 1.1, Frequency, severity, seriousness, and relatedness of treatment-emergent adverse events (AEs), Serum concentrations of zanidatamab as a function of time post-dosing, Frequency, duration, and time of onset of antizanidatamab antibodies and neutralizing antibodies, if applicable, to zanidatamab, Time to definitive deterioration (TDD) from baseline in the IHC 3+ subgroup in patientreported global health status (GHS) score as measured by the European Organisation for Research and Treatment of Cancer (EORTC) Quality of Life Questionnaire – Core 30 (QLQC30), TDD from baseline in the overall population in patientreported GHS score as measured by the EORTC QLQC30, Change from baseline in health economics and outcomes research/patient-reported outcome (HEOR/PRO) parameters using the EORTC QLQC30, Quality of Life Questionnaire – Cholangiocarcinoma and Gallbladder Cancer module (QLQ-BIL21), and 5level EuroQol5 Dimension (EQ-5D-5L)

Source: https://euclinicaltrials.eu/ctis-public/view/2023-508219-21-00